EU clinical trial 2024-519935-41-00: Efficacy and safety of a 4 year pubertal therapy with growth hormone (Omnitrope) or growth hormone and an aromatase inhibitor (Letrozole) in boys with a short predicted height.
Protocol code: BSGPE2
Sponsor: Universitair Ziekenhuis Antwerpen (Hospital/Clinic/Other health care facility). Phase: Therapeutic confirmatory (Phase III). Countries: Belgium (authorised, recruitment pending).
Therapeutic area(s): Diseases [C] - Hormonal diseases [C19]
Gender: Male. Age: 0-17 years. Enrolment: 50.
Status: Authorised, recruitment pending. Decision date: 2025-01-10. Results received: No. Last updated: 2025-01-10.

Condition(s): Short predicted height
Product: Omnitrope 10 mg/1.5 ml solution for injection in cartridge, Letrozole Fair-Med Healthcare 2.5 mg film coated tablets

Primary endpoint: Adult height gain = Final height minus predicted adult height

Source: https://euclinicaltrials.eu/ctis-public/view/2024-519935-41-00